EU clinical trial 2022-502837-24-00: J2A-MC-GZGQ: A Phase 3, Randomized, Double-Blind Study to Investigate the Efficacy and Safety of Once-Daily Oral LY3502970 Compared With Placebo in Adult Participants With Obesity or Overweight and Type 2 Diabetes (ATTAIN-2)
Protocol code: J2A-MC-GZGQ
Sponsor: Eli Lilly & Co. (Pharmaceutical company). Phase: Therapeutic confirmatory (Phase III). Countries: Czechia (ended), Germany (ended), Greece (ended).
Therapeutic area(s): Diseases [C] - Nutritional and Metabolic Diseases [C18]
Gender: Female, Male. Age: 18-64 years, 65+ years. Enrolment: 390.
Status: Ended. Start date (EU): 2023-09-25. End date (EU): 2025-08-07. End date: 2025-08-08. Decision date: 2023-09-19. Results received: Yes. Last updated: 2025-08-12.
Decision dates by country: DE: 2023-09-19, CZ: 2023-09-25, GR: 2023-09-22

Condition(s): Overweight, Obesity, Type 2 Diabetes
Product: ORFORGLIPRON, Orforglipron, ORFORGLIPRON, Sodium bicarbonate - Placebo to match ly3502970, ORFORGLIPRON, ORFORGLIPRON, ORFORGLIPRON

Primary endpoint: Mean Percent Change from Baseline in Body Weight (from Baseline to Week 72)

Source: https://euclinicaltrials.eu/ctis-public/view/2022-502837-24-00